EU clinical trial 2024-515308-38-00: COURAGE - Corticosteroid in acute urticaria in emergency department
Protocol code: P160913
Sponsor: Assistance Publique Hopitaux De Paris (Hospital/Clinic/Other health care facility). Phase: Therapeutic confirmatory (Phase III). Countries: France (ended).
Therapeutic area(s): Diseases [C] - Skin and Connective Tissue Diseases [C17]
Gender: Female, Male. Age: 18-64 years, 65+ years. Enrolment: 240.
Status: Ended. Start date (EU): 2019-09-21. End date (EU): 2025-09-17. Decision date: 2024-08-13. Results received: No. Last updated: 2024-08-13.

Condition(s): Adults patients with isolated acute urticaria presenting to the emergency department
Product: CORTANCYL 20 mg, comprimé sécable, Placebo of CORTANCYL 20 mg

Primary endpoint: 7-Days Urticaria Activity Score (UAS 7) at day 7

Source: https://euclinicaltrials.eu/ctis-public/view/2024-515308-38-00